EU clinical trial 2025-521128-31-00: A Phase Ib/ II Multicenter, Open-Label, Randomized Study Evaluating the Safety, Pharmacokinetics, and Activity of GDC-4198 Alone and in Combination with Giredestrant in Comparison with Abemaciclib and Giredestrant in Participants with Locally Advanced or Metastatic Estrogen Receptor-Positive, HER2-Negative Breast Cancer who Have Previously Progressed During or After a CDK4/6 Inhibitor
Protocol code: GO46021
Sponsor: Genentech Inc. (Pharmaceutical company). Phase: Phase I and Phase II (Integrated)- Other. Countries: Spain (ongoing, recruiting), Italy (authorised, recruiting), France (ongoing, recruiting), Germany (authorised, recruiting).
Therapeutic area(s): Diseases [C] - Neoplasms [C04]
Gender: Female, Male. Age: 18-64 years, 65+ years. Enrolment: 73.
Start date (EU): 2025-12-18. Decision date: 2025-11-26. Results received: No. Last updated: 2026-01-14.
Decision dates by country: FR: 2025-11-26, DE: 2025-11-26, IT: 2025-11-26, ES: 2025-11-26

Condition(s): Locally Advanced or Metastatic Estrogen Receptor-Positive, human epidermal growth factor receptor 2-negative (HER2-Negative) Breast Cancer who Have Previously Progressed During or After a cyclin-dependent kinase 4/6 (CDK4/6) Inhibitor
Product: RO7840734, RO7840734, ABEMACICLIB, RO7197597, ABEMACICLIB, ABEMACICLIB

Primary endpoint: Incidence and severity of adverse events, with severity determined according to the National Cancer Institute's Common Terminology Criteria for Adverse Events (CTCAE v5.0) grading scale, Change from baseline in selected vital signs, Change from baseline in selected clinical laboratory test results, Incidence and nature of dose-limiting toxicities (DLTs), Progression-free survival
Endpoint(s): Phase Ib Stage: Overall Response Rate (ORR), Phase Ib Stage:Clinical Benefit Rate (CBR), Phase Ib Stage:Area under the concentration time-curve from Time 0 to last measurable concentration (AUC0-t), area under the concentration time-curve from Time 0 to infinity (AUCinf), and maximum serum Concentration (Cmax) following administration of a single dose of GDC-4198 under fasted and fed conditions, Phase II Stage: Overall Response Rate (ORR), Phase II Stage:Duration of Response (DOR), Phase II Stage: Clinical Benefit Rate (CBR), Phase II Stage: Overall Survival (OS), Phase II Stage: OS rate at 6 months and 12 months, Phase II Stage: PFS rate at 6 months and 12 months, Phase II Stage:Incidence and severity of adverse events, with severity determined according to the CTCAE v5.0 grading scale, Phase II Stage: Change from baseline in selected vital signs, Phase II Stage: Change from baseline in selected clinical laboratory test results, Phase II Stage:Plasma concentrations of GDC-4198 and its metabolites at specified timepoints, Phase II Stage: Relationship between GDC-4198 dose and safety, pharmacokinetics, and efficacy

Source: https://euclinicaltrials.eu/ctis-public/view/2025-521128-31-00